EU clinical trial 2025-524438-24-00: A Phase 1/2 Open-Label, Single Ascending Dose, First-In-Human Study to Assess Safety and Tolerability of Endoscopic Ultrasound-Guided Pancreatic Infusion of RJVA-001 in Adults With Inadequately Controlled Type 2 Diabetes on Multiple Glucose-Lowering Agents.
Protocol code: RJVA-001-01
Sponsor: Fractyl Health Inc. (Pharmaceutical company). Phase: Phase I and Phase II (Integrated)- First administration to humans. Countries: Netherlands (authorised, recruitment pending).
Therapeutic area(s): Diseases [C] - Nutritional and Metabolic Diseases [C18]
Gender: Female, Male. Age: 18-64 years, 65+ years. Enrolment: 15.
Status: Authorised, recruitment pending. Decision date: 2026-04-23. Results received: No. Last updated: 2026-07-24.

Condition(s): Type 2 Diabetes
Product: RJVA-001

Primary endpoint: Incidence, severity, dose-relationship of Adverse Events and changes in laboratory evaluations.
Endpoint(s): 1. Change in transgene secretion and glycemic parameters., 2. Anti-AAV9 antibody titers, anti-GLP-1 antibody titers and enzyme-linked immunosorbent spot for AAV9 and GLP-1., 3. Digital polymerase chain reaction for AAV9 in samples., 4. Change from Baseline parameters using continuous glucose monitoring.

Source: https://euclinicaltrials.eu/ctis-public/view/2025-524438-24-00